EU clinical trial 2022-502703-30-00: Continuing Somatostatin Analogues Upon progression in Neuroendocrine tumour pAtients (SAUNA trial)
Protocol code: SAUNA
Sponsor: Antwerp University Hospital (Hospital/Clinic/Other health care facility). Phase: Therapeutic use (Phase IV). Countries: Netherlands (ongoing, recruiting), Belgium (ongoing, recruiting).
Therapeutic area(s): Diseases [C] - Neoplasms [C04]; Diseases [C] - Digestive System Diseases [C06]
Gender: Female, Male. Age: 18-64 years, 65+ years. Enrolment: 270.
Status: Ongoing, recruiting. Start date (EU): 2023-06-28. Decision date: 2023-05-31. Results received: No. Last updated: 2025-09-24.
Decision dates by country: NL: 2023-05-31, BE: 2023-05-31

Condition(s): neuroendocrine tumours
Product: OCTREOTIDE, EVEROLIMUS, LANREOTIDE, SUNITINIB, LUTETIUM (177LU) OXODOTREOTIDE

Primary endpoint: The difference in PFS between patients continuing or stopping SSA after initiating PRRT, as assessed by blinded local radiologists on cross-sectional imaging; progression is defined through RECIST 1.1 standardized framework., The difference in PFS between patients continuing or stopping SSA after initiating targeted therapy, as assessed by blinded local radiologists on cross-sectional imaging; progression is defined through RECIST 1.1 standardized framework., The difference in TTD in patients continuing or stopping second-line therapy with SSAs after initiating PRRT., The difference in TTD in patients continuing or stopping second-line therapy with SSAs after initiating targeted therapy.
Endpoint(s): PFS rate according to RECIST 1.1 at 18 months per substudy, The difference in pooled PFS and TTD of both substudies, Overall survival per substudy and pooled over both substudies, Response rates per substudy and pooled over both substudies, Quality of life (QoL), Cost-effectiveness, Toxicity

Source: https://euclinicaltrials.eu/ctis-public/view/2022-502703-30-00